EU clinical trial 2024-517397-25-00: FT819 in B-cell Mediated Autoimmune Diseases
Protocol code: FT819-102
Sponsor: Fate Therapeutics Inc. (Pharmaceutical company). Phase: Human Pharmacology (Phase I)- First administration to humans. Countries: France (authorised, recruiting), Sweden (ongoing, recruiting), Germany (not authorised).
Therapeutic area(s): Diseases [C] - Immune System Diseases [C20]
Gender: Female, Male. Age: 18-64 years, 65+ years. Enrolment: 50.
Start date (EU): 2026-01-26. Decision date: 2025-09-30. Results received: No. Last updated: 2026-03-04.
Decision dates by country: SE: 2025-09-30, FR: 2025-10-02

Condition(s): B-cell Mediated Autoimmune Diseases

Source: https://euclinicaltrials.eu/ctis-public/view/2024-517397-25-00